EU clinical trial 2025-524821-42-00: Erdosteine effect on oxidative stress, inflammatory response and immune modulation in patients with COPD. A single center, open label, double arm, controlled, 4-week, explorative, ex vivo study.
Sponsor: ASST Fatebenefratelli Sacco (Hospital/Clinic/Other health care facility). Phase: Therapeutic use (Phase IV). Countries: Italy (ongoing, recruiting).
Therapeutic area(s): Diseases [C] - Respiratory Tract Diseases [C08]
Gender: Female, Male. Age: 18-64 years, 65+ years. Enrolment: 30.
Status: Ongoing, recruiting. Start date (EU): 2026-07-06. Decision date: 2026-05-20. Results received: No. Last updated: 2026-05-20.

Condition(s): COPD
Product: ESTECLIN 300 MG CAPSULE RIGIDE

Primary endpoint: Difference from baseline in relative GPX2 (glutathione peroxidase 2) expression and GPX2 enzyme quantification in peripheral blood after 30 days of treatment with erdosteine+ standard of care.
Endpoint(s): Difference between baseline and end of treatment in relative GPX2 (glutathione peroxidase 2) expression and GPX2 enzyme concentration in peripheral blood in patients exposed to Erdosteine + Standard of Care (Treatment arm A) and patients not exposed to Erdosteine (Treatment arm B)., Difference from baseline after 30 days of treatment in relative expression and concentration of immune response pathways related cytokines/chemokines and oxidative stress mediators in peripheral blood of patients exposed to Erdosteine + Standard of Care (Treatment arm A)., Difference from baseline after 30 days of treatment in relative expression and concentration of immune response pathways related cytokines/chemokines and oxidative stress mediators in peripheral blood of patients exposed to Erdosteine + Standard of Care (Treatment arm A) compared with patients treated with Standard of Care (Treatment arm B)., Difference from baseline after 30 days of treatment in functional characterization by means of flow cytometry of Th 1 (CD4/T-bet/IFN-γ/IL-2), Th 17 (CD4/Rorγt/IL-17/IL-21) and Treg (CD4/C25/Foxp3/IL-10/TGF-β/CTLA-4) in peripheral blood of patients exposed to Erdosteine + Standard of Care (Treatment arm A) compared with patients treated with Standard of Care (Treatment arm B).

Source: https://euclinicaltrials.eu/ctis-public/view/2025-524821-42-00